EU clinical trial 2025-524177-16-00: An open-label, single-center, non-controlled pilot clinical trial to assess the efficacy of weekly semaglutide in combination with regular counselling sessions to reduce craving and use of chemsex associated drugs (CoSem4Chemsex) study.
Sponsor: Institute Of Tropical Medicine (Hospital/Clinic/Other health care facility). Phase: Therapeutic exploratory (Phase II). Countries: Belgium (ongoing, recruiting).
Therapeutic area(s): Psychiatry and Psychology [F] - Behavior and Behavior Mechanisms [F01]
Gender: Male. Age: 18-64 years, 65+ years. Enrolment: 22.
Status: Ongoing, recruiting. Start date (EU): 2026-06-23. Decision date: 2026-02-12. Results received: No. Last updated: 2026-04-21.

Condition(s): Craving for and use of chemsex-related drugs
Product: Ozempic 0.25 mg solution for injection in pre-filled pen, Ozempic 0.5 mg solution for injection in pre-filled pen, Ozempic 1 mg solution for injection in pre-filled pen

Primary endpoint: Craving for CADs (the highest craving score for cathinones / crystallized methamphetamine / GHB/GBL) at baseline and each subsequent study visit (Penn Craving Score)
Endpoint(s): Self-reported use CADs, Self-reported use crystallized methamphetamine, Self-reported use cathinones, Self-reported use GHB/GBL, Craving for crystallized methamphetamine at baseline and end of treatment, Craving for cathinones at baseline and end of treatment, Craving for GHB/GBL at baseline and end of treatment, Craving for alcohol at baseline and end of treatment, Quality of life at baseline and end of treatment, Craving for CADs (sum of craving for cathinones + crystallized methamphetamine + GHB/GBL) at baseline and end of treatment (VAS), The cumulative proportion of participants reporting grade 3 to 5 of each side effect listed in the SAFTEE form over the course of the study whilst receiving semaglutide

Source: https://euclinicaltrials.eu/ctis-public/view/2025-524177-16-00